EU clinical trial 2024-515244-22-00: An Open-label, Single-dose, Safety and Pharmacokinetic Study of Regadenoson in Paediatric Patients
Protocol code: GE-262-001
Sponsor: GE Healthcare Limited (Pharmaceutical company). Phase: Phase I and Phase II (Integrated)- Other. Countries: France (ended), Greece (ended), Italy (ongoing, recruitment ended).
Therapeutic area(s): Analytical, Diagnostic and Therapeutic Techniques and Equipment [E] - Diagnosis [E01]
Gender: Female, Male. Age: 0-17 years. Enrolment: 3.
Start date (EU): 2024-09-09. Decision date: 2024-09-09. Results received: No. Last updated: 2025-11-12.
Decision dates by country: FR: 2024-09-23, GR: 2024-09-09, IT: 2024-10-08

Condition(s): Patients who need to undergo a clinically indicated pharmacologic stress perfusion CMR test and who are considered fit for a pharmacological stress perfusion CMR by the investigator. The pharmacologic stress perfusion CMR may be performed in patients for further evaluation of cardiovascular conditions or diseases, such as, but not limited to, Kawasaki disease, congenital heart diseases, congenital coronary abnormalities, and post-cardiac surgery / transplantation, etc.
Product: Gadovist 1.0 mmol/ml solution for injection, Rapiscan 400 microgram solution for injection

Primary endpoint: Primary Safety Endpoints: Occurrence of AEs, including AEs of special interest (AESIs), changes in physical examination, vital signs (BP, HR, RR, oxygen saturation, body temperature), ECG evaluation, clinical laboratory tests (serum chemistry), and post-regadenoson dosing concomitant medications. Evaluation will begin at the time of patient consent for the trial and continue through completion of the study or early withdrawal/termination. Collection of AEs will continue through study completion, or withdrawal/termination after the final PK blood draw (at 2 hours post-regadenoson dose) with an additional recommended observation as considered appropriate based on the patient’s condition and/or local standard of care practice and during the follow-up phone call or clinic visit at 48 hours (±12 hours)., Primary Pharmacokinetic Endpoints: The plasma samples for measurement of regadenoson concentrations will be collected at 1, 3, 5, 10, and 20 minutes and 1 and 2 hours post-regadenoson dose. Concentration-time profiles will be evaluated using compartmental methods and a population approach with mixed-effect modelling., The effect of patient factors (such as, but not limited to, age, gender, body weight, height, body mass index [BMI], body surface area [BSA], renal function [SCr, eGFR]) on the PK variables will be assessed.
Endpoint(s): "Secondary Pharmacodynamic Endpoints: The relationship between regadenoson PK variables/exposure and changes in HR will be assessed, including impact of patient factors (e.g., age, gender, body weight, height, BMI, BSA, renal function [SCr, eGFR])."

Source: https://euclinicaltrials.eu/ctis-public/view/2024-515244-22-00